EU clinical trial 2022-501420-20-00: ISIS 678354-CS6 A Randomized, Double-Blind, Placebo-Controlled, Phase 3 Study of Olezarsen (ISIS 678354) Administered Subcutaneously to Patients with Severe Hypertriglyceridemia
Protocol code: ISIS 678354-CS6
Sponsor: Ionis Pharmaceuticals Inc. (Pharmaceutical company). Phase: Therapeutic confirmatory (Phase III). Countries: France (ended), Italy (ended), Hungary (ended), Belgium (ended), Poland (ended), Slovakia (ended), Czechia (ended), Netherlands (ended), Spain (ended), Sweden (ended), Bulgaria (ended), Greece (ended), Lithuania (ended), Portugal (ended), Romania (ended).
Therapeutic area(s): Diseases [C] - Congenital, Hereditary, and Neonatal Diseases and Abnormalities [C16]
Gender: Female, Male. Age: 18-64 years, 65+ years. Enrolment: 248.
Status: Ended. Start date (EU): 2023-05-17. End date (EU): 2025-09-12. End date: 2025-09-13. Decision date: 2023-03-28. Results received: No. Last updated: 2025-09-03.
Decision dates by country: SE: 2023-04-21, IT: 2023-03-29, SK: 2023-04-03, RO: 2023-07-03, BE: 2023-08-21, HU: 2023-03-30, PT: 2023-07-19, PL: 2023-04-03, CZ: 2023-04-21, FR: 2023-03-28, ES: 2023-04-21, NL: 2023-04-21, LT: 2023-07-18, BG: 2023-04-03, GR: 2023-08-17

Condition(s): Severe hypertryglyceridemia
Product: ISIS 678354, Placebo Injection, 0.8 mL is a sterile, preservative-free, parenteral solution of sodium chloride and riboflavin in water for injection (WFI) intended for subcutaneous injection

Primary endpoint: Percent Change from Baseline in Fasting TG Compared to Placebo [Time Frame: Baseline and Month 6]
Endpoint(s): Percent Change from Baseline in Fasting TG Compared to Placebo [Time Frame: Baseline and Month 12], Percent Change from Baseline in Fasting Apolipoprotein C-III (ApoC-III), Remnant Cholesterol and Non-High-Density Lipoprotein-Cholesterol (Non-HDL-C) Compared to Placebo [Time Frame: Baseline, Month 6 and 12], Proportion of Patients who Achieve Fasting TG <500 mg/dL (5.65 mmol/L) Compared to Placebo [Time Frame: Month 12], Proportion of Patients Who Achieve Fasting TG < 880 mg/dL (10 mmol/L) Compared to Placebo in the Subgroup of Patients with Baseline TG ≥ 880 mg/dL [Time Frame: Month 12], Adjudicated Acute Pancreatitis Event Rate During the Treatment Period Compared to Placebo [Time Frame: Week 1 through Week 53], Absolute Change in Hepatic Fat Fraction (HFF) Between Olezarsen Treatment Group and Placebo

Source: https://euclinicaltrials.eu/ctis-public/view/2022-501420-20-00